EU clinical trial 2024-516692-32-00: A study of the safety, tolerability, biological effect, and efficacy of allogenic natural killer cells in combination with trastuzumab and pertuzumab in adult patients with refractory metastatic Her2 positive breast cancer
Protocol code: VHIO20002
Sponsor: Vall D Hebron Institute Of Oncology (Laboratory/Research/Testing facility). Phase: Human Pharmacology (Phase I)- Other. Countries: Spain (ended).
Therapeutic area(s): Diseases [C] - Neoplasms [C04]
Gender: Female. Age: 18-64 years, 65+ years. Enrolment: 20.
Status: Ended. Start date (EU): 2022-05-26. End date (EU): 2025-04-30. Decision date: 2024-10-21. Results received: No. Last updated: 2025-02-19.

Condition(s): Refractory metastatic Her2 positive breast cancer

Source: https://euclinicaltrials.eu/ctis-public/view/2024-516692-32-00